EU clinical trial 2024-518215-18-00: An open-label, single-center, exploratory study of the safety and efficacy of avalglucosidase alfa in patients with non-classic Pompe disease aged ≥ 5 years.
Protocol code: GZ-2016-11512
Sponsor: Erasmus Universitair Medisch Centrum Rotterdam (Erasmus MC) (Hospital/Clinic/Other health care facility). Phase: Therapeutic use (Phase IV). Countries: Netherlands (ongoing, recruiting).
Therapeutic area(s): Diseases [C] - Musculoskeletal Diseases [C05]; Diseases [C] - Congenital, Hereditary, and Neonatal Diseases and Abnormalities [C16]
Gender: Female, Male. Age: 0-17 years, 18-64 years. Enrolment: 6.
Status: Ongoing, recruiting. Start date (EU): 2024-10-16. Decision date: 2024-10-16. Results received: No. Last updated: 2025-02-05.

Condition(s): Glycogen storage disease type II or acid maltase deficiency, Pompe disease
Product: Nexviadyme 100 mg powder for concentrate for solution for infusion

Primary endpoint: Safety and tolerability are determined by assessing: • The number of AE’s/treatment-emergent adverse events, including infustion associated reactions • The occurrence of antibodies against avalglucosidase alfa • Clinical laboratory evaluations aimed at liver and muscle function (ASAT/ALAT/CK), Pharmacokinetics: • Single and multiple dose estimates for Cmax, AUC, CL, Efficacy is determined by assessing: • Changes in muscle strength: Manual Muscle Testing (MMT), Hand-Held dynamometry (HHD) • Changes in muscle function: Quick Motor Function Test (QMFT), 6-Minute Walk Test(6-MWT), Timed tests • Changes in the pulmonary function o Forced vital capacity in sitting and supine positions, Maximum Inpiratory Pressure (MIP), Maximum Expiratory Pressure (MEP) • Changes in PRO-Measures: Rasch-build Pompe Activity Scale (R-PaCT), Quality of life, modified Borg scale

Source: https://euclinicaltrials.eu/ctis-public/view/2024-518215-18-00